EU clinical trial 2023-509258-71-00: A Phase 1, First-in-Human, Dose Escalation Study of JNJ-88998377 in Participants with Relapsed/Refractory B-cell NHL
Protocol code: 88998377LYM1001
Sponsor: Janssen Cilag International (Pharmaceutical company). Phase: Human Pharmacology (Phase I)- First administration to humans. Countries: Italy (ongoing, recruitment ended), Poland (ongoing, recruitment ended).
Therapeutic area(s): Diseases [C] - Neoplasms [C04]
Gender: Female, Male. Age: 18-64 years, 65+ years. Enrolment: 30.
Status: Ongoing, recruitment ended. Start date (EU): 2024-07-24. Decision date: 2024-07-03. Results received: No. Last updated: 2025-12-08.
Decision dates by country: PL: 2024-07-05, IT: 2024-07-03

Condition(s): relapsed or refractory B‑cell non-Hodgkin lymphomas

Source: https://euclinicaltrials.eu/ctis-public/view/2023-509258-71-00